EU clinical trial 2024-511979-15-00: HOVON 161: A phase II non-inferiority study comparing point-of-care produced CAR T-cell to commercial CAR T-cells in patients with relapsed/refractory Non-Hodgkin Lymphoma
Protocol code: HO161
Sponsor: Universitair Medisch Centrum Groningen (Hospital/Clinic/Other health care facility). Phase: Therapeutic exploratory (Phase II). Countries: Netherlands (ongoing, recruiting).
Therapeutic area(s): Diseases [C] - Neoplasms [C04]
Gender: Female, Male. Age: 18-64 years, 65+ years. Enrolment: 340.
Status: Ongoing, recruiting. Start date (EU): 2022-10-14. Decision date: 2024-10-29. Results received: No. Last updated: 2025-05-22.

Condition(s): relapsed/refractory Non-Hodgkin Lymphoma
Product: ARI-0001, YESCARTA 0.4 – 2 x 10e8 cells dispersion for infusion

Primary endpoint: PFS from date of IMP infusion (if applicable).
Endpoint(s): PFS from date of randomization., Safety and toxicity assessment of ARI-0001 CAR T-cells and Axi-cel per AE reporting classified according to CTCAE Version 5 and CRS and ICANS classified according to the ASTCT criteria., Overall response rate (ORR, sum of complete response [CR] and partial response [PR]), as well as CR, PR, SD and PD/relapse at 4 weeks, 12 weeks, 6, 12 and 24 months after infusion of CAR T-cells., Expansion, phenotype and persistence of ARI-0001 CAR T-cells in both treatment arms., Best overall response (BOR) rate at 4 weeks, 12 weeks, 6, 12 and 24 months after infusion of CAR T-cells., Duration of response (DOR)., OS from date of randomization, and from date of CAR T-cell infusion (if applicable)., Patient Reported Outcome/Quality of Life (PRO/QOL)., CAR T-cell expansion, persistence, and T-cell characteristics in both treatment arms (ARI-0001 vs Axi-cel)., PoC CAR T-cell production characteristics (e.g. number of viable T-cells, transduction efficiency, T-cell subsets (activated T-cells, memory T-cells)), including the functional characteristics (e.g. potency tests) between the different production sites., The association of the functional characteristics (e.g. potency tests) of the CAR T-cell products (ARI-0001 CAR T-cells) with CAR T-cell expansion, persistence, adverse events, response rates and progression free survival., Proportion of successful batches between the different production sites., Number of days between leukapheresis and infusion of CAR T-cells (vein-to-vein time)., Fludarabine pharmacokinetics.

Source: https://euclinicaltrials.eu/ctis-public/view/2024-511979-15-00